EU clinical trial 2022-502917-27-00: Longterm, openlabel (doseblinded), extension study of eptinezumab in children and adolescents with chronic or episodic migraine
Protocol code: 19379A
Sponsor: H. Lundbeck A/S (Pharmaceutical company). Phase: Therapeutic confirmatory (Phase III). Countries: Italy (ongoing, recruiting), Portugal (ongoing, recruiting), Spain (ongoing, recruiting), Poland (ongoing, recruiting).
Therapeutic area(s): Diseases [C] - Nervous System Diseases [C10]
Gender: Female, Male. Age: 0-17 years. Enrolment: 276.
Status: Ongoing, recruiting. Start date (EU): 2023-03-07. Decision date: 2024-04-05. Results received: No. Last updated: 2026-07-24.
Decision dates by country: IT: 2024-05-13, PT: 2024-04-05, ES: 2024-04-09, PL: 2025-06-16

Condition(s): Migraine
Product: VYEPTI 100 mg concentrate for solution for infusion

Primary endpoint: Number of Participants With Treatment Emergent Adverse Events
Endpoint(s): Free Eptinezumab Plasma Concentration, Number of Participants With Specific Anti-Eptinezumab Antibodies (Anti-Drug Antibodies [ADA]), Number of Participants With Specific Anti-Eptinezumab Antibodies for Neutralizing Activity (NAb), Change From Baseline in Pediatric Migraine Disability Assessment Questionnaire (PedMIDAS) Score at Weeks 12, 24, and 36

Source: https://euclinicaltrials.eu/ctis-public/view/2022-502917-27-00